EU clinical trial 2024-512278-92-00: A Phase 2, Multicenter, Single-blinded, Randomized Study to Evaluate the Pharmacokinetics and Safety of Sotatercept (MK-7962) Administered Using Either a Weight-based or Weight-banded Approach in Participants With Pulmonary Arterial Hypertension (PAH) on Standard of Care
Protocol code: MK-7962-024
Sponsor: Merck Sharp & Dohme LLC (Pharmaceutical company). Phase: Therapeutic exploratory (Phase II). Countries: Czechia (ended), Poland (ended), Spain (ended), France (ended), Germany (ended), Italy (ended), Netherlands (ended), Hungary (ended).
Therapeutic area(s): Diseases [C] - Cardiovascular Diseases [C14]
Gender: Female, Male. Age: 18-64 years, 65+ years. Enrolment: 81.
Status: Ended. Start date (EU): 2024-12-09. End date (EU): 2025-11-20. End date: 2026-01-15. Decision date: 2024-11-25. Results received: No. Last updated: 2025-08-28.
Decision dates by country: CZ: 2024-11-27, NL: 2024-12-02, FR: 2024-11-25, IT: 2024-11-26, ES: 2024-11-28, HU: 2024-11-26, PL: 2024-12-02, DE: 2024-12-20

Condition(s): Pulmonary Arterial Hypertension (PAH)
Product: SOTATERCEPT, sotatercept, sotatercept, SOTATERCEPT

Primary endpoint: Steady-state average serum concentrations of sotatercept (Cavg), Number of participants who experience one or more adverse events (AEs), Number of participants who discontinue study intervention due to an AE
Endpoint(s): Initial dose average serum concentrations of sotatercept (Cavg)

Source: https://euclinicaltrials.eu/ctis-public/view/2024-512278-92-00